EU clinical trial 2024-511881-35-00: A Phase 3, Randomized, Double-Blind, Placebo-Controlled, Efficacy and Safety Study of Povorcitinib in Participants With Prurigo Nodularis
Protocol code: INCB 54707-306
Sponsor: Incyte Corp. (Pharmaceutical company). Phase: Therapeutic confirmatory (Phase III). Countries: Belgium (ongoing, recruitment ended), Germany (ongoing, recruitment ended), Spain (ongoing, recruitment ended), Czechia (ongoing, recruitment ended), Poland (ongoing, recruitment ended).
Therapeutic area(s): Diseases [C] - Immune System Diseases [C20]; Diseases [C] - Skin and Connective Tissue Diseases [C17]
Gender: Female, Male. Age: 18-64 years, 65+ years. Enrolment: 170.
Status: Ongoing, recruitment ended. Start date (EU): 2024-12-17. Decision date: 2024-12-03. Results received: No. Last updated: 2026-04-09.
Decision dates by country: PL: 2024-12-09, ES: 2024-12-03, DE: 2024-12-03, BE: 2024-12-05, CZ: 2024-12-05

Condition(s): Prurigo Nodularis
Product: Povorcitinib, Placebo to Povorcitinib, Povorcitinib

Primary endpoint: Proportion of participants achieving Itch NRS4 (≥ 4-point improvement [reduction] in Itch NRS score from baseline) and IGA-CPG-S-TS (IGA CPG-S score of 0 or 1 with a ≥ 2-grade improvement from baseline) at Week 24
Endpoint(s): Proportion of participants achieving Itch NRS4 at Week 24, Proportion of participants achieving IGA CPG S-TS at Week 24, Proportion of participants achieving Itch NRS4 at Week 4

Source: https://euclinicaltrials.eu/ctis-public/view/2024-511881-35-00